EU clinical trial 2023-505655-43-00: A Phase I, open-label, multi-center exploratory safety and efficacy study with PSMA, SSTR2 and GRPR targeted radioligand therapy in metastatic neuroendocrine prostate cancer
Protocol code: CAAA617H12101
Sponsor: Novartis Pharma AG (Pharmaceutical company). Phase: Phase I and Phase II (Integrated)- First administration to humans. Countries: France (ongoing, recruitment ended), Germany (ongoing, recruitment ended), Italy (ended), Spain (ongoing, recruitment ended).
Therapeutic area(s): Diseases [C] - Neoplasms [C04]
Gender: Male. Age: 18-64 years, 65+ years. Enrolment: 20.
Start date (EU): 2024-07-29. Decision date: 2024-05-08. Results received: No. Last updated: 2026-07-16.
Decision dates by country: IT: 2024-05-13, ES: 2024-05-09, FR: 2024-05-14, DE: 2024-05-08

Condition(s): Metastatic neuroendocrine prostate cancer

Source: https://euclinicaltrials.eu/ctis-public/view/2023-505655-43-00